EU clinical trial 2022-501540-15-00: A Phase 3, 24-week, Randomized, Placebo-controlled, Double-blind Study to Assess the Efficacy, Safety and Tolerability of Rocatinlimab (AMG 451) Monotherapy in Adult Subjects With Moderate-to-severe Atopic Dermatitis (AD) (ROCKET-Ignite)
Protocol code: 20210142
Sponsor: Amgen Inc. (Pharmaceutical company). Phase: Therapeutic confirmatory (Phase III). Countries: Poland (ended), Netherlands (ended), Portugal (ended), Germany (ended), Slovakia (ended), Italy (ended), Latvia (ended), Spain (ended), Croatia (ended), Greece (ended), Czechia (ended), Hungary (ended).
Therapeutic area(s): Diseases [C] - Immune System Diseases [C20]
Gender: Female, Male. Age: 18-64 years, 65+ years. Enrolment: 317.
Status: Ended. Start date (EU): 2023-04-25. End date (EU): 2024-09-03. End date: 2025-01-13. Decision date: 2023-03-27. Results received: Yes. Last updated: 2024-12-04.
Decision dates by country: NL: 2023-04-03, PL: 2023-04-03, IT: 2023-03-30, DE: 2023-05-26, CZ: 2023-03-30, HR: 2023-04-03, PT: 2023-03-29, LV: 2023-04-03, ES: 2023-03-27, HU: 2023-04-20, GR: 2023-03-28, SK: 2023-03-27

Condition(s): Atopic Dermatitis
Product: Placebo for AMG 451 will be presented in identical containers, and stored/packaged the same as rocatinlimab, Rocatinlimab

Primary endpoint: Achieving a vIGA-AD score of 0 (clear) or 1 (almost clear) with ≥ 2-point reduction from baseline (vIGA-AD 0/1) at week 24, Achieving ≥ 75% reduction from baseline in EASI score (EASI 75) at week 24
Endpoint(s): Achieving EASI 75 at week 16, Achieving vIGA-AD 0/1 at week 16, Achieving from baseline in weekly average of daily worst pruritus numeric rating scale (NRS) score at week 16 in subjects with baseline weekly average of daily worst pruritus NRS score Achieving from baseline in weekly average of daily worst pruritus NRS score at week 24 in subjects with baseline weekly average of daily worst pruritus NRS score, Achieving ≥ 90% reduction from baseline in EASI score (EASI 90) at week 24, Acheiving from baseline in weekly average of AD skin pain NRS score at week 24 in subjects with baseline weekly average of AD skin pain NRS score., Achieving Clear skin at week 24 for subjects with hand AD at baseline, Acheiving from baseline in weekly average of AD skin pain NRS score at week 24 in subjects with baseline weekly average of AD skin pain NRS score., Achieving vIGA-AD 1 response with presence of only barely perceptible erythema or vIGA-AD 0 response (revised Investigator's Global Assessment [rIGA] 0/1) at week 24

Source: https://euclinicaltrials.eu/ctis-public/view/2022-501540-15-00